EU clinical trial 2022-502494-41-00: A phase 2 trial of Gremubamab compared to placebo in participants with bronchiectasis and chronic Pseudomonas aeruginosa infection
Protocol code: 1-023-22
Sponsor: NHS Tayside, University Of Dundee (Hospital/Clinic/Other health care facility, Educational Institution). Phase: Therapeutic exploratory (Phase II). Countries: Spain (ended).
Therapeutic area(s): Diseases [C] - Respiratory Tract Diseases [C08]
Gender: Female, Male. Age: 18-64 years, 65+ years. Enrolment: 30.
Status: Ended. Start date (EU): 2023-11-21. End date (EU): 2024-07-09. End date: 2024-07-10. Decision date: 2023-09-19. Results received: Yes. Last updated: 2024-08-12.

Condition(s): bronchiectasis and chronic Pseudomonas aeruginosa infection
Product: MEDI3902 PBO 4mL 10R

Primary endpoint: Day 84
Endpoint(s): From Baseline to; Days 7, 14, 28 and 56, From Baseline to; Day 168, From Baseline to; Days 84 and 168, From Baseline to; Days 28, 56, 84 and 168, From Baseline to; First event from visit 1 to day 84, From Baseline to; Day 28, 56 and 84, From Baseline to; Over 168 days, From Baseline to; Over 168 days

Source: https://euclinicaltrials.eu/ctis-public/view/2022-502494-41-00